EU clinical trial 2023-506236-32-00: A Phase 3, Randomized, Double-Blind Study to Evaluate the Safety, Tolerability, and Immunogenicity of V116 in Children and Adolescents With Increased Risk of Pneumococcal Disease.
Protocol code: V116-013
Sponsor: Merck Sharp & Dohme LLC (Pharmaceutical company). Phase: Therapeutic confirmatory (Phase III). Countries: Sweden (ended), Poland (ended), France (ended), Finland (ended), Spain (ended).
Therapeutic area(s): Diseases [C] - Bacterial Infections and Mycoses [C01]
Gender: Female, Male. Age: 0-17 years. Enrolment: 215.
Status: Ended. Start date (EU): 2024-03-25. End date (EU): 2025-02-25. End date: 2025-03-06. Decision date: 2024-03-18. Results received: Yes. Last updated: 2025-02-25.
Decision dates by country: FR: 2024-03-21, SE: 2024-03-21, FI: 2024-03-21, ES: 2024-05-29, PL: 2024-03-25

Condition(s): Pneumococcal disease
Product: Pneumovax® 23 solution for injection in pre-filled syringe Pneumococcal Polysaccharide Vaccine, V110, Pneumococcal 21-valent Conjugate Vaccine

Primary endpoint: Percentage of participants with solicited injection-site adverse events (AEs), Percentage of participants with solicited systemic AEs, Percentage of participants with vaccine-related serious adverse events (SAEs), Geometric mean titers (GMTs) of serotype-specific opsonophagocytic activity (OPA) following vaccination
Endpoint(s): Geometric mean concentrations (GMCs) of serotype-specific Immunoglobulin G (IgG) after vaccination, Geometric mean fold rise (GMFR) from baseline in serotype-specific OPA GMTs, Percentage of participants with ≥4-fold rise from baseline in serotype-specific OPAs GMTs, GMFR from baseline in serotype-specific IgG GMCs, Percentage of participants with ≥4-fold rise from baseline in serotype-specific IgG GMCs

Source: https://euclinicaltrials.eu/ctis-public/view/2023-506236-32-00